EU clinical trial 2023-503949-65-00: A research study comparing the effect of different dosing conditions on blood levels of semaglutide in a new tablet composition in healthy participants
Protocol code: NN9924-4977
Sponsor: Novo Nordisk A/S (Pharmaceutical company). Phase: Human Pharmacology (Phase I)- Other. Countries: Germany (ended).
Therapeutic area(s): Diseases [C] - Nutritional and Metabolic Diseases [C18]
Gender: Male. Age: 18-64 years. Enrolment: 120.
Status: Ended. Start date (EU): 2023-08-07. End date (EU): 2024-04-18. Decision date: 2023-07-21. Results received: No. Last updated: 2023-12-12.

Condition(s): Type 2 Diabetes

Source: https://euclinicaltrials.eu/ctis-public/view/2023-503949-65-00